EU clinical trial 2023-509825-38-00: A Randomized, Open-Label, Phase 3 Study to Evaluate Zimberelimab and Domvanalimab in Combination with Chemotherapy Versus Pembrolizumab With Chemotherapy for the First-Line Treatment of Patients With Metastatic Non–Small Cell Lung Cancer With No Epidermal Growth Factor Receptor or Anaplastic Lymphoma Kinase Genomic Tumor Aberrations
Protocol code: GS-US-626-6216
Sponsor: Gilead Sciences Inc. (Pharmaceutical company). Phase: Therapeutic confirmatory (Phase III). Countries: Spain (ongoing, recruitment ended), Portugal (ended), Italy (ended), France (ended), Austria (ended), Germany (ended), Netherlands (ongoing, recruitment ended), Belgium (ended).
Therapeutic area(s): Diseases [C] - Neoplasms [C04]
Gender: Female, Male. Age: 18-64 years, 65+ years. Enrolment: 322.
Start date (EU): 2022-12-01. Decision date: 2024-07-17. Results received: No. Last updated: 2026-06-29.
Decision dates by country: FR: 2024-07-23, BE: 2024-07-19, PT: 2024-07-18, NL: 2024-07-22, AT: 2024-07-23, IT: 2024-08-19, DE: 2024-07-26, ES: 2024-07-17

Condition(s): Metastatic Non–Small Cell Lung Cancer
Product: Abraxane 5 mg/ml powder for dispersion for infusion., PACLITAXEL, CARBOPLATIN, KEYTRUDA 25 mg/mL concentrate for solution for infusion, DOMVANALIMAB, ALIMTA 500 mg powder for concentrate for solution for infusion, CISPLATIN, Zimberelimab

Primary endpoint: OS is defined as the time from the date of randomization to the date of death from any cause (both in participants with positive PD-L1 expression [≥ 1% TC] and in all randomized participants as dual primary endpoints)
Endpoint(s): PFS is defined as the time from the date of randomization until progressive disease (PD) as assessed by BICR according to RECIST v1.1 or death from any cause, whichever comes first. , ORR is defined as the proportion of participants who have achieved a complete response (CR) or partial response (PR) that is confirmed at least 4 weeks later as assessed by BICR according to RECIST v1.1, DOR is defined as the time from the first response (CR or PR), to the first documented PD, as assessed by BICR according to RECIST v1.1, or death from any cause, whichever comes first., Incidence, severity, seriousness, and relatedness of treatment-emergent adverse events (TEAEs) and incidence and severity of clinical laboratory abnormalities, Time to first symptom deterioration in NSCLC SAQ shortness of breath domain, Time to first deterioration in NSCLC-SAQ total score

Source: https://euclinicaltrials.eu/ctis-public/view/2023-509825-38-00